EU clinical trial 2024-516791-15-00: A Phase II, Open-Label, Multicenter Study to Evaluate the Optimization of the Cytokine Release Syndrome Profile for Glofitamab in Combination with Gemcitabine Plus Oxaliplatin in Patients with Relapsed/Refractory Aggressive B-Cell Non-Hodgkin’s Lymphoma
Protocol code: GO45434
Sponsor: F. Hoffmann-La Roche AG (Pharmaceutical company). Phase: Therapeutic exploratory (Phase II). Countries: Italy (ongoing, recruiting), Germany (ongoing, recruitment ended), France (ongoing, recruiting).
Therapeutic area(s): Diseases [C] - Neoplasms [C04]
Gender: Female, Male. Age: 18-64 years, 65+ years. Enrolment: 26.
Start date (EU): 2025-04-08. Decision date: 2025-03-19. Results received: No. Last updated: 2026-07-02.
Decision dates by country: IT: 2025-03-19, DE: 2025-03-19, FR: 2025-03-24

Condition(s): Relapsed/Refractory Aggressive B-Cell Non-Hodgkin’s Lymphoma (NHL)

Primary endpoint: 1. Incidence of CRS: Grade 2 or higher CRS at any time during the study, determined according to the ASTCT CRS grading criteria, 2. Incidence of CRS: Any Grade CRS, at any time during the study
Endpoint(s): 1. Incidence of serious CRS events, with severity determined according to the ASTCT CRS grading criteria, 2. CRS frequency relative to the start of the infusion of each of the step-up doses of glofitamab, 3. CRS management, including outcome of patients who experienced a CRS event, 4. Incidence and severity of adverse events, with severity determined according to the NCI CTCAE v5.0 , except CRS, ICANS, and HLH that will be graded using ASTCT grading criteria (Lee et al. 2019; Hines et al. 2023), 5. Tolerability, as assessed by dose interruptions, dose reductions, and dose intensity, 6. Study treatment discontinuation because of adverse events, 7. Complete response (CR) rate, 8. Objective response rate (ORR), 9. Duration of response (DOR), 10. Duration of complete response (DOCR), 11. Progression-free survival (PFS), 12. Overall survival (OS)

Source: https://euclinicaltrials.eu/ctis-public/view/2024-516791-15-00